EU clinical trial 2024-518778-15-00: Randomized, double-blind, Phase 2/3 study of IV amisulpride as prevention of post-operative nausea and vomiting in pediatric patients
Protocol code: DP-10027
Sponsor: Acacia Pharma Limited (Pharmaceutical company). Phase: Therapeutic confirmatory (Phase III). Countries: France (ended), Germany (ended).
Therapeutic area(s): Analytical, Diagnostic and Therapeutic Techniques and Equipment [E] - Anesthesia and Analgesia [E03]
Gender: Female, Male. Age: 0-17 years. Enrolment: 200.
Status: Ended. Start date (EU): 2023-10-08. End date (EU): 2025-05-30. End date: 2025-06-03. Decision date: 2025-01-14. Results received: No. Last updated: 2025-05-20.
Decision dates by country: DE: 2025-01-22, FR: 2025-01-14

Condition(s): post-operative nausea and vomiting in pediatric patients
Product: Amisulpride, DEXAMETHASONE PHOSPHATE, ONDANSETRON

Primary endpoint: Complete Response (absence of PONV), defined as no vomiting/retching and no use of anti-emetic rescue medication, during the first 24 hours after completion of surgery
Endpoint(s): Efficacy: Occurrence of post-operative vomiting/retching, Efficacy: Use of rescue medication, Efficacy: Occurrence and severity of post-operative nausea, Efficacy: Time to emergence of PONV, Efficacy: Time to emergence of vomiting/retching, significant nausea, and rescue medication, individually, Efficacy: Different variables (complete response, vomiting/retching, use of rescue medication) during different time ranges after the end of surgery (0-2 h, 2-6 h and 6-24 h), Efficacy: The above variables in the sub-groups of patients who did and did not receive opioid analgesia, Safety: The nature and frequency of adverse events and laboratory and ECG abnormalities, Key pharmacokinetics parameters

Source: https://euclinicaltrials.eu/ctis-public/view/2024-518778-15-00